EU clinical trial 2023-503529-20-00: A Phase II, Multicentre, Open-Label Study to Assess the Efficacy and Safety of Olaparib Monotherapy and Olaparib Plus Durvalumab Combination as Neoadjuvant Therapy in Patients with BRCA Mutations and Early Stage HER2- negative Breast Cancer (OlympiaN)
Protocol code: OlympiaN
Sponsor: AstraZeneca AB (Pharmaceutical company). Phase: Therapeutic exploratory (Phase II). Countries: Germany (ended), Belgium (ended), Austria (ended), Italy (ended), Spain (ended).
Therapeutic area(s): Diseases [C] - Neoplasms [C04]
Gender: Female, Male. Age: 18-64 years, 65+ years. Enrolment: 40.
Status: Ended. Start date (EU): 2022-10-17. End date (EU): 2025-09-05. End date: 2025-09-17. Decision date: 2024-09-26. Results received: No. Last updated: 2025-09-09.
Decision dates by country: DE: 2024-09-30, ES: 2024-10-08, AT: 2024-09-29, BE: 2024-09-26, IT: 2024-10-01

Condition(s): BRCA Mutations and Early Stage HER2-Negative Breast Cancer
Product: IMFINZI 50 mg/mL concentrate for solution for infusion., INFLIXIMAB, Lynparza 100 mg film-coated tablets, MYCOPHENOLATE MOFETIL, Lynparza 150 mg film-coated tablets

Primary endpoint: pCR is defined as ypT0/Tis ypN0 (ie, no invasive residual in breast and the axillary lymph nodes on evaluation of the complete resected breast specimen and all sampled regional lymph nodes) following completion of neoadjuvant systemic therapy
Endpoint(s): pCR is defined as ypT0/Tis ypN0 (ie, no invasive residual in breast and the axillary lymph nodes on evaluation of the complete resected breast specimen and all sampled regional lymph nodes) following completion of neoadjuvant systemic therapy., RCB index value using 6 variables to categorize response in 1 of 4 classes: RCB 0 (pCR), I (minimal RCB), II (moderate RCB), and III (extensive RCB)., Percentage change in tumour volume from baseline after 3 and 6 cycles of treatment will be measured using MRI., EFS is defined as time from the first dose of study intervention administration to any of the following events: progression of disease that precludes surgery, local or distant recurrence after surgery, second primary malignancy (breast or other invasive cancers), or death due to any cause., Safety and tolerability will be evaluated in terms of AEs/SAEs, physical examination, vital signs including blood pressure, pulse, heart rate, body temperature, body weight and height, clinical laboratory assessments including clinical chemistry/haematology parameters, and ECGs.

Source: https://euclinicaltrials.eu/ctis-public/view/2023-503529-20-00